EU clinical trial 2023-507450-32-00: Evaluating the efficacy and safety of hyperbaric oxygen therapy as an adjuvant treatment compared to biologic therapy alone in moderate to severe ulcerative colitis in adults
Protocol code: NBK121/1/2023
Sponsor: Medical University Of Gdansk (Educational Institution). Phase: Therapeutic confirmatory (Phase III). Countries: Poland (ended).
Therapeutic area(s): Diseases [C] - Immune System Diseases [C20]; Diseases [C] - Digestive System Diseases [C06]
Gender: Female, Male. Age: 18-64 years, 65+ years. Enrolment: 40.
Status: Ended. End date (EU): 2025-07-10. Decision date: 2024-05-07. Results received: Yes. Last updated: 2024-12-02.

Condition(s): Ulcerative colitis
Product: STELARA 130 mg concentrate for solution for infusion, STELARA 90 mg solution for injection in pre-filled pen, Entyvio 300 mg powder for concentrate for solution for infusion, Zessly 100 mg powder for concentrate for solution for infusion, TLEN MEDYCZNY Linde gaz, STELARA 90 mg solution for injection in pre-filled syringe

Primary endpoint: The percentage of clinical remission after 12 months of treatment, i.e. the percentage of patients who achieved complete resolution of clinical symptoms of exacerbation of ulcerative colitis (diarrhea and blood in the stool), as well as resolution of endoscopic markers of mucosal inflammation.
Endpoint(s): 1. Assessment of the clinical response rate in the group of patients receiving combination therapy compared to the group of patients receiving biological therapy alone after 14 weeks and 12 months after administration of the first dose of biological drug. 2. Assessment of the percentage of complete clinical remission in the group of patients receiving combined treatment compared to the group of patients receiving biological treatment alone 14 weeks after administration of the first dose of the b

Source: https://euclinicaltrials.eu/ctis-public/view/2023-507450-32-00